EU clinical trial 2024-511599-33-00: A Phase 3 Open-Label, Randomized Study of Pirtobrutinib (LOXO-305) versus Bendamustine plus Rituximab in Untreated Patients with Chronic Lymphocytic Leukemia/Small Lymphocytic Lymphoma (BRUIN-CLL-313)
Protocol code: LOXO-BTK-20023
Sponsor: Loxo Oncology Inc. (Pharmaceutical company). Phase: Therapeutic confirmatory (Phase III). Countries: France (ongoing, recruitment ended), Bulgaria (ongoing, recruitment ended), Czechia (ongoing, recruitment ended), Italy (ongoing, recruitment ended), Poland (ongoing, recruitment ended), Hungary (ongoing, recruitment ended), Austria (ongoing, recruitment ended), Spain (ongoing, recruitment ended), Romania (ongoing, recruitment ended), Portugal (ongoing, recruitment ended).
Therapeutic area(s): Diseases [C] - Neoplasms [C04]
Gender: Female, Male. Age: 18-64 years, 65+ years. Enrolment: 166.
Status: Ongoing, recruitment ended. Start date (EU): 2021-12-22. Decision date: 2024-05-28. Results received: No. Last updated: 2026-08-03.
Decision dates by country: BG: 2024-05-28, RO: 2024-06-04, CZ: 2024-05-30, ES: 2024-05-30, AT: 2024-05-31, PL: 2024-05-31, PT: 2024-05-29, IT: 2024-06-03, HU: 2024-05-28, FR: 2024-05-31

Condition(s): Chronic Lymphocytic Leukemia/Small Lymphocytic Lymphoma
Product: PIRTOBRUTINIB, PIRTOBRUTINIB, BENDAMUSTINE, RITUXIMAB

Primary endpoint: Assessed by IRC: PFS per iwCLL 2018 response criteria

Source: https://euclinicaltrials.eu/ctis-public/view/2024-511599-33-00